EU clinical trial 2024-516104-42-00: HTLP-onco-adult - A phase I/II Study evaluating the safety and the efficacy of Human T Lymphoid Progenitor (HTLP) injection to accelerate immune reconstitution after umbilical cord blood (UCB) transplantation in adult patients with hematologic malignancies
Protocol code: APHP191116
Sponsor: Assistance Publique Hopitaux De Paris (Hospital/Clinic/Other health care facility). Phase: Human Pharmacology (Phase I)- First administration to humans. Countries: France (ongoing, recruiting).
Therapeutic area(s): Diseases [C] - Immune System Diseases [C20]
Gender: Female, Male. Age: 18-64 years, 65+ years. Enrolment: 10.
Status: Ongoing, recruiting. Start date (EU): 2022-02-17. Decision date: 2024-08-20. Results received: No. Last updated: 2026-07-03.

Condition(s): hematologic malignancies ; acute myeloid leukemias

Source: https://euclinicaltrials.eu/ctis-public/view/2024-516104-42-00